EU clinical trial 2023-510548-19-00: A Phase 2B Randomized, Double-Blind, Placebo-Controlled Study of the Efficacy and Safety of Namodenoson in the Treatment of Non-Alcoholic Steatohepatitis (NASH)
Protocol code: CF102-212LD
Sponsor: Can-Fite Biopharma Ltd. (Pharmaceutical company). Phase: Therapeutic exploratory (Phase II). Countries: Romania (ongoing, recruiting), Bulgaria (ongoing, recruiting), Poland (authorised, recruitment pending).
Therapeutic area(s): Diseases [C] - Digestive System Diseases [C06]
Gender: Female, Male. Age: 18-64 years, 65+ years. Enrolment: 90.
Start date (EU): 2023-03-02. Decision date: 2024-11-11. Results received: No. Last updated: 2026-05-29.
Decision dates by country: BG: 2024-11-11, RO: 2024-11-11, PL: 2026-05-29

Condition(s): Non-Alcoholic Steatohepatitis (NASH) with F1-3 fibrosis
Product: Namodenoson, Matching placebo for namodenoson

Primary endpoint: Proportion of subjects who achieve a ≥2-point improvement in NAS (Week 36, relative to Baseline)
Endpoint(s): The mean PCFB in serum ALT level (Week 36, relative to Baseline)

Source: https://euclinicaltrials.eu/ctis-public/view/2023-510548-19-00